EU clinical trial 2025-521852-45-00: An Open-Label, Phase 2 Study to Evaluate the Efficacy, Safety and Pharmacokinetics of PTX-100 Monotherapy in Patients with Relapsed or Refractory Cutaneous T-Cell Lymphoma.
Protocol code: PTX-100-02-2024
Sponsor: Prescient Therapeutics Limited (Pharmaceutical company). Phase: Therapeutic exploratory (Phase II). Countries: Italy (ongoing, recruiting), France (authorised, recruitment pending).
Therapeutic area(s): Diseases [C] - Neoplasms [C04]
Gender: Female, Male. Age: 18-64 years, 65+ years. Enrolment: 25.
Start date (EU): 2026-01-22. Decision date: 2025-12-08. Results received: No. Last updated: 2026-05-05.
Decision dates by country: FR: 2025-12-08, IT: 2025-12-09

Condition(s): Cutaneous T-Cell Lymphoma
Product: PTX-100

Primary endpoint: Objective response rate (ORR)
Endpoint(s): Further Efficacy: - Skin response as per Modified Severity-Weighted Assessment Tool (mSWAT) - Progression-free survival (PFS) - Duration of response (DOR) - Time to response (TTR) - Complete response rate (CRR) - Overall survival (OS) - Time to next (systemic) treatment (TTNT), Safety and Tolerability - Incidence, severity and nature of adverse events (AEs) - Changes from Baseline in vital signs, electrocardiogram (ECG), clinical laboratory values and Eastern Cooperative Oncology Group (ECOG) performance status (PS), PK: - PK parameters including: Cmax Tmax, Cmin, AUCtau, AUClast, AUCinf, kel, half-life (t1/2), total body CLss, Vzss, Cmax ratio (Rac-Cmax), and AUC Ratio (Rac-AUC) - Population PK model development (NCM) from data of Phase 2a and Phase 2b data - Population and individual patient PK parameters estimation

Source: https://euclinicaltrials.eu/ctis-public/view/2025-521852-45-00